EU clinical trial 2023-507254-32-00: DASSOH - Systematic use of DDAVP to prevent serum sodium overcorrection in severe hyponatremia : a multicenter open-label randomized controlled trial
Protocol code: APHP220676
Sponsor: Assistance Publique Hopitaux De Paris (Hospital/Clinic/Other health care facility). Phase: Therapeutic confirmatory (Phase III). Countries: France (ongoing, recruiting).
Therapeutic area(s): Diseases [C] - Pathological Conditions, Signs and Symptoms [C23]; Analytical, Diagnostic and Therapeutic Techniques and Equipment [E] - Therapeutics [E02]
Gender: Female, Male. Age: 18-64 years, 65+ years. Enrolment: 260.
Status: Ongoing, recruiting. Start date (EU): 2024-12-17. Decision date: 2024-05-16. Results received: No. Last updated: 2026-07-08.

Condition(s): Severe hyponatremia and a high risk of rapid SNa overcorrection
Product: SODIUM LACTATE, GLUCOSE 5 % VIAFLO, solution pour perfusion, GLUCOSE 2,5 % B. BRAUN, solution pour perfusion, GADOTERIC ACID, CHLORURE DE SODIUM 0,9 % AGUETTANT, solution pour perfusion, MINIRIN 4 microgrammes/ml, solution injectable, CHLORURE DE POTASSIUM B. BRAUN 10 % (0,10 g/ml), solution à diluer pour perfusion, CHLORURE DE SODIUM HYPERTONIQUE 10 % LAVOISIER, solution à diluer injectable

Primary endpoint: Proportion of patients with SNa level overcorrection at any time during the first 48h after randomization., SNa overcorrection is defined according to presence or absence of risk factors at the time of randomization (chronic alcohol abuse, malnutrition, thiazides or antidepressant medicines, serum potassium<3.0mmol/L, glycaemia>20mmol/L) for CPM: • Patients with any risk factor: SNa increase>6.0 mmol/L in less than 24h, or a SNa increase>12.0 mmol/L in less than 48h. • Patients without risk factor: SNa increase>10.0mmol/L in less than 24h, or a SNa increase>18.0 mmol/L in less than 48h.
Endpoint(s): Proportion of patients with neurological symptoms seizure, confusion, signs of brain herniation) and who subsequently have a normal Glasgow Coma Scale (15/15) at H6, Length of ICU and hospital stay, Time to death after inclusion, Proportion of patients with the occurrence of central pontine myelinolysis diagnosed on clinical and MRI criteria at day 15 + 5 days (or earlier if clinically justified), Proportion of patients with any (pontine or extrapontine), symptomatic or not, osmotic demyelination as assessed by brain MRI at day 15 + 5 days (or earlier if clinically justified), Proportion of patients with neurological symptoms with an increase of 5.0 mmol/L or more of SNa from inclusion to H6, Urine output between (i) H0 and H6, (ii) H6 and H12, (iii) H12 and H24, and (iv) H24 and H48, Urine osmolality between (i) H0 and H6, (ii) H6 and H12, (iii) H12 and H24, and (iv) H24 and H48, Slope of the SNa increase between (i) H0 and H24 and (ii) H0 and H48, Maximum change of SNa from baseline between (i) H0 and H24 and (ii) H0 and H48, Serum renin, apelin, Co-peptine and aldosterone concentration at H0, H6, H24, H48, Total amount of intravenous hypotonic fluids administered between (i) H0 and H24 and (ii) H24 and H48, Total amount of sodium and potassium administered between (i) H0 and H24 and (ii) H24 and H48, Proportion of patients with seizures, confusion or sign of brain herniation appearing or reappearing after inclusion, Occurrence of a reduction of SNa of 5.0 mmol/L or more from inclusion between H0 and H48

Source: https://euclinicaltrials.eu/ctis-public/view/2023-507254-32-00